EU clinical trial 2024-513098-31-00: An Open Label, Phase 2 Clinical Trial of MEN1703 as Monotherapy and in Combination with Glofitamab in Patients with Relapsed or Refractory Aggressive B-cell Non-Hodgkin Lymphoma (JASPIS-01)
Protocol code: JASPIS-01
Sponsor: Ryvu Therapeutics S.A. (Pharmaceutical company). Phase: Therapeutic exploratory (Phase II). Countries: Poland (ongoing, recruiting), France (ongoing, recruiting), Spain (ongoing, recruiting).
Therapeutic area(s): Diseases [C] - Neoplasms [C04]
Gender: Female, Male. Age: 18-64 years, 65+ years. Enrolment: 118.
Status: Ongoing, recruiting. Start date (EU): 2024-11-14. Decision date: 2024-10-28. Results received: No. Last updated: 2025-11-25.
Decision dates by country: PL: 2024-10-28, ES: 2025-02-10, FR: 2025-01-23

Condition(s): Relapsed or Refractory Aggressive B-cell Non-Hodgkin Lymphoma
Product: Columvi 10 mg concentrate for solution for infusion, MEN1703 oral capsule 100 mg, MEN1703 oral capsule 25 mg, Gazyvaro 1,000 mg concentrate for solution for infusion., Columvi 2.5 mg concentrate for solution for infusion

Primary endpoint: • Group 1 and 2: Incidence and severity of adverse events (AE), • Group 1: Complete Response (CR) rate, assessed by Independent Review Committee (IRC) following the Lugano Classification (see Section 16), • Group 2: Over all response rate (ORR), assessed by Independent Review Committee (IRC) following the Lugano Classification (see Section 16 of the protocol)
Endpoint(s): • Group 1: Complete Response (CR) rate, assessed locally following the Lugano classification (see Section 16), • Group 2: Overall Response Rate (ORR), assessed locally following the Lugano classification (see Section 16 of the protocol), • Group 1: The following endpoint measures are assessed by IRC and locally following the Lugano Classification (see Section 16): Overall Response Rate (ORR); Duration of Response (DoR); Duration of Complete Response (DoCR); Progression-free survival (PFS); Overall survival (OS); Time to response; Time to next treatment), • Group 2: The following endpoint measures are assessed by IRC and locally following the Lugano Classification (see Section 16 of the protocol): Complete Response (CR) Rate; Duration of Response (DoR); Duration of Complete Response (DoCR); Progression-free survival (PFS); Overall survival (OS); Time to response; Time to next treatment), • Group 1 and 2: Incidence and severity of AEs; PK of MEN1703 including Cmax, tmax, AUCtau, AUCinf, and t½; Changes in lymphoma symptoms, well-being, and general health status measured by FACT–Lym and EORTC QLQ C30

Source: https://euclinicaltrials.eu/ctis-public/view/2024-513098-31-00